EU clinical trial 2025-520676-26-00: Phase II trial of amivantamab plus monochemotherapy in platinum unfit NSCLC patients with EGFR exon20 insertion mutations
Sponsor: Fondazione Ricerca Traslazionale (Laboratory/Research/Testing facility). Phase: Therapeutic exploratory (Phase II). Countries: Italy (authorised, recruitment pending).
Therapeutic area(s): Diseases [C] - Neoplasms [C04]
Gender: Female, Male. Age: 18-64 years, 65+ years. Enrolment: 35.
Status: Authorised, recruitment pending. Decision date: 2025-09-11. Results received: No. Last updated: 2026-07-24.

Condition(s): Non-small cell lung cancer (NSCLC)
Product: JNJ-61186372, Pemetrexed Ever Pharma 25 mg/ml concentrato per soluzione per infusione

Primary endpoint: Objective Response Rate (ORR) according to RECIST 1.1
Endpoint(s): Median PFS, Median OS, Duration of response, Safety

Source: https://euclinicaltrials.eu/ctis-public/view/2025-520676-26-00